EU clinical trial 2025-521062-10-00: A Study to Evaluate the Safety and Tolerability of ARV-806 in Adults with Advanced Cancer that has the KRAS G12D Mutation
Protocol code: ARV-806-101
Sponsor: Arvinas Operations Inc. (Pharmaceutical company). Phase: Human Pharmacology (Phase I)- First administration to humans. Countries: Spain (authorised, recruitment pending), Italy (authorised, recruitment pending).
Therapeutic area(s): Diseases [C] - Neoplasms [C04]
Gender: Female, Male. Age: 18-64 years, 65+ years. Enrolment: 51.
Status: Authorised, recruitment pending. Decision date: 2026-03-12. Results received: No. Last updated: 2026-03-16.
Decision dates by country: IT: 2026-03-12, ES: 2026-03-16

Condition(s): KRAS G12D Mutated Advanced Solid Tumors

Source: https://euclinicaltrials.eu/ctis-public/view/2025-521062-10-00